EU clinical trial 2026-525517-31-00: A PHASE 1, OPEN-LABEL, SINGLE-DOSE MASS BALANCE AND METABOLITE PROFILING STUDY OF 14C-LABELED IZICOPAN (INF904) IN HEALTHY MALE PARTICIPANTS
Protocol code: INF904-P1.2
Sponsor: InflaRx GmbH (Pharmaceutical company). Phase: Human Pharmacology (Phase I)- Other. Countries: Netherlands (ongoing, recruitment ended).
Therapeutic area(s): Not possible to specify
Gender: Male. Age: 18-64 years. Enrolment: 8.
Status: Ongoing, recruitment ended. Start date (EU): 2026-05-04. Decision date: 2026-05-01. Results received: No. Last updated: 2026-05-01.

Condition(s): Not applicable, healthy volunteers

Source: https://euclinicaltrials.eu/ctis-public/view/2026-525517-31-00